EU clinical trial 2023-504861-22-00: A Phase 2 Open-label Study to Evaluate the Safety, Tolerability, Pharmacokinetics, and Pharmacodynamics of Sotatercept (MK-7962) in Children from 1 to Less Than 18 Years of Age With PAH on Standard of Care
Protocol code: MK-7962-008
Sponsor: Merck Sharp & Dohme LLC (Pharmaceutical company). Phase: Therapeutic exploratory (Phase II). Countries: Poland (ongoing, recruiting), Germany (ongoing, recruiting), France (ongoing, recruiting), Netherlands (ongoing, recruiting), Spain (ongoing, recruiting).
Therapeutic area(s): Diseases [C] - Respiratory Tract Diseases [C08]
Gender: Female, Male. Age: 0-17 years. Enrolment: 22.
Status: Ongoing, recruiting. Start date (EU): 2023-05-05. Decision date: 2023-11-27. Results received: No. Last updated: 2026-05-19.
Decision dates by country: ES: 2023-11-27, FR: 2023-12-01, NL: 2023-11-27, PL: 2023-11-27, DE: 2023-11-28

Condition(s): Pulmonary arterial hypertension
Product: SOTATERCEPT, sotatercept

Primary endpoint: Serum Trough Concentration (Ctrough) of Sotatercept, Area Under the Curve at Steady State (AUCss) of Sotatercept, Area Under the Curve from 0 to 3 weeks (AUC0-3 weeks) of Sotatercept, Percentage of Participants Who Experience at Least 1 Adverse Event (AE), Percentage of Participants Who Discontinue Study Drug Due to an AE, Laboratory Parameter (Hematology): Concentration of Hemoglobin, Laboratory Parameter (Hematology): Hematocrit, Laboratory Parameter (Hematology): RBC Count, Laboratory Parameter (Hematology): Reticulocyte Count, Laboratory Parameter (Hematology): Platelet Count, Blood Pressure (BP), Titer of Anti-drug Antibody (ADA) to Sotatercept
Endpoint(s): Mean Change from Baseline in 6-Minute Walk Distance (6MWD) (Cohorts 1 and 2), Mean Change from Baseline in Tricuspid Annular Plane Systolic Excursion (TAPSE), Mean Change from Baseline in Pulmonary Artery Systolic Pressure (PASP), Mean Change from Baseline in Right Ventricular Fractional Area Change (RVFAC), Mean Change from Baseline in Eccentricity Index, Mean Change from Baseline in Right Ventricular (RV) Function (Cohorts 1 and 2), Mean Change from Baseline on Cardiac Output (Cohorts 1 and 2), Mean Change from Baseline in Pulmonary Arterial Pressure (PAP) (Cohorts 1 and 2), Mean Change from Baseline in Pediatric Quality of Life (PedsQL) Generic Score, Mean Change from Baseline in N-terminal Prohormone B-type Natriuretic Peptide (NT-proBNP), Percentage of Participants who Either Improved or Maintained Their World Health Organization Functional Class (WHO FC)

Source: https://euclinicaltrials.eu/ctis-public/view/2023-504861-22-00